EU clinical trial 2022-501139-17-01: A Phase 2 clinical trial of Pembrolizumab in combination with Carboplatin and Cabazitaxel in Aggressive Variant Metastatic Castration Resistant Prostate Cancer
Protocol code: PEAPOD-FOS04/2022
Sponsor: Fundación Oncosur (Laboratory/Research/Testing facility). Phase: Therapeutic exploratory (Phase II). Countries: Spain (ended).
Therapeutic area(s): Diseases [C] - Male Urogenital Diseases [C12]; Diseases [C] - Neoplasms [C04]
Gender: Male. Age: 18-64 years, 65+ years. Enrolment: 42.
Status: Ended. Start date (EU): 2023-05-05. End date (EU): 2026-06-30. Decision date: 2022-10-25. Results received: No. Last updated: 2025-06-06.

Condition(s): Aggressive Variant Metastatic Castration Resistant Prostate Cancer
Product: KEYTRUDA 25 mg/mL concentrate for solution for infusion, CARBOPLATIN, CABAZITAXEL

Primary endpoint: Radiographic Progression-free survival (rPFS) rate at 6 months. Radiographic Progression-Free Survival is defined from the date of first dose of study treatment to the date of radiographic confirmed progression or death (from any cause), whichever occurs first, Incidence of adverse events (AEs) graded according to NCI-CTCAE v 5.0 criteria
Endpoint(s): Radiographic Progression free-survival at 12 months, Response rate by PCWG3 modified RECIST 1.1, PSA response (when PSA is evaluable), PSA progression-free survival, Progression-free survival, Overall survival, Abnormalities in vital signs, laboratory test values, and ECG data, Treatment modifications, Patients’ withdrawals for safety reasons, Exploratory biomarkers (including but not limited to proteins, tumor tissue-derived DNA and circulating cell-free DNA) will be collected before treatment, during treatment and at disease progression, We will determine androgen receptor N-terminus (AR441, Carpinteria, CA, USA), androgen receptor C-terminus (SP242, Abcam, Cambridge, UK) and Ki67 (M724001-2, Dako, Glostrup, Denmark)., We will collect and analyze tumor tissue, whole blood and plasma nucleic acids (DNA and RNA) in future research.

Source: https://euclinicaltrials.eu/ctis-public/view/2022-501139-17-01